EU clinical trial 2024-514085-39-00: RUBIKID - Dynamic 82-Rb positron emission tomography (PET) for the grading of KIDney carcinoma
Protocol code: APHP231442
Sponsor: Assistance Publique Hopitaux De Paris (Hospital/Clinic/Other health care facility). Phase: Therapeutic exploratory (Phase II). Countries: France (ongoing, recruiting).
Therapeutic area(s): Diseases [C] - Neoplasms [C04]
Gender: Female, Male. Age: 18-64 years, 65+ years. Enrolment: 60.
Status: Ongoing, recruiting. Start date (EU): 2026-03-03. Decision date: 2025-08-06. Results received: No. Last updated: 2025-08-06.

Condition(s): Kidney carcinoma
Product: RUBIDIUM CHLORIDE

Primary endpoint: Intensity of 82-Rb uptake in the tumor calculated as the tumor to background ratio (ratio between SUV max in the tumor and the mean SUV in normal renal parenchyma).
Endpoint(s): Renal perfusion flow measured on 82-Rb-PET and the degree of neoangiogenesis in the tumor., Imaging biomarkers on 82-Rb-PET and the histological type of the tumor, Imaging biomarkers on 82-Rb-PET and tumor aggressiveness (ISUP grades) in patients with clear-cell renal adenocarcinomas., Rubidium uptake measured on 82-Rb-PET and degree of tumor vascularization measured on immuno-histology (CD34 and VEGF immunostaining)., Estimated residual renal function based on 82-Rb-PET and change of creatinine clearance between baseline and three months after surgery., Percentage of patients reclassified according to the gold-standard (ISUP grade of clear-cell renal adenocarcinomas on pathology)., The serious adverse events (SAE) related to 82-Rb

Source: https://euclinicaltrials.eu/ctis-public/view/2024-514085-39-00